EU clinical trial 2023-505712-37-00: A Phase 2/3, adaptive, randomized, open-label, clinical study to evaluate neoadjuvant and adjuvant V940 (mRNA-4157) in combination with pembrolizumab (MK-3475) versus standard of care, and pembrolizumab monotherapy in participants with resectable locally advanced cutaneous squamous cell carcinoma (LA cSCC) (INTerpath-007).
Protocol code: V940-007
Sponsor: Merck Sharp & Dohme LLC (Pharmaceutical company). Phase: Phase II and Phase III (Integrated). Countries: Italy (ended), Czechia (ended), Romania (ended), Hungary (ended), Poland (ended), Belgium (ended), France (ended), Spain (ended), Norway (ended), Germany (ended).
Therapeutic area(s): Diseases [C] - Neoplasms [C04]
Gender: Female, Male. Age: 18-64 years, 65+ years. Enrolment: 242.
Status: Ended. Start date (EU): 2024-06-06. End date (EU): 2026-03-05. End date: 2026-03-06. Decision date: 2024-05-23. Results received: No. Last updated: 2026-04-27.
Decision dates by country: HU: 2024-05-28, NO: 2024-05-23, FR: 2024-05-27, CZ: 2024-05-23, PL: 2024-05-27, RO: 2024-05-28, BE: 2024-05-23, ES: 2024-05-24, IT: 2024-05-24, DE: 2024-05-24

Condition(s): The participants must have a histologically confirmed diagnosis of resectable cSCC as the primary site of malignancy (metastatic skin involvement from another primary cancer or from an unknown primary cancer is not permitted).
Product: mRNA-4157, KEYTRUDA 25 mg/mL concentrate for solution for infusion

Primary endpoint: Event-Free Survival
Endpoint(s): Objective Response Rate, Freedom From Surgery Rate, Pathologic Complete Response Rate, Major Pathologic Response Rate, Disease-Specific Survival, Overall Survival, Percentage of Participants Who Experience an Adverse Event (AE), Percentage of Participants Who Discontinue Study Intervention Due to AEs

Source: https://euclinicaltrials.eu/ctis-public/view/2023-505712-37-00